EU clinical trial 2024-517219-56-00: Safety and efficacy of steering of immunosuppression based on BKPyV-specific T cells in case of BK Polyomavirus (BKPyV) DNAe- mia after kidney transplantation
Protocol code: SAFE-BK
Sponsor: Paediatrisches Forschungsnetzwerk gGmbH, PROFIL Institut fuer Stoffwechselforschung GmbH (Laboratory/Research/Testing facility, Pharmaceutical company). Phase: Therapeutic use (Phase IV). Countries: Germany (authorised, recruitment pending).
Therapeutic area(s): Phenomena and Processes [G] - Immune system processes [G12]; Diseases [C] - Virus Diseases [C02]
Gender: Female, Male. Age: 0-17 years, 18-64 years, 65+ years. Enrolment: 300.
Status: Authorised, recruitment pending. Decision date: 2025-04-17. Results received: No. Last updated: 2026-08-04.

Condition(s): BK Polyomavirus DNAemia after kidney transplantation
Product: TACROLIMUS, CICLOSPORIN, MYCOPHENOLATE MOFETIL, SIROLIMUS, AZATHIOPRINE, MYCOPHENOLIC ACID, EVEROLIMUS, PREDNISOLONE, BELATACEPT

Primary endpoint: Time from randomization to end of BKPyV-DNAemia, where end of BKPyV-DNAemia is defined as the first time point after randomization with BKPyV DNA <1,000 IU/ml or a decline in BKPyV DNA of >1 log10 IU/ml (>90% curtailing) as the best-established surrogate marker in the literature for clearance of BKPyV infection.
Endpoint(s): Change from baseline to month 9 in estimated glomerular filtration rate (eGFR), Occurrence of acute rejection episodes, Occurrence of donor-specific antibodies, Occurrence of graft loss, Number and dose of immunosuppressants, Trough levels of immunosuppressants, Overall and CNI immunosuppressive scale (IS) units, Level of BKPyV-specific CD4 T cells, Occurrence of BKPyV re-infections

Source: https://euclinicaltrials.eu/ctis-public/view/2024-517219-56-00